EU clinical trial 2023-505279-62-00: A Phase 1/2a Study of Safety, Pharmacokinetics and Neutralizing Activity of SPK002 as pre-exposure prophylaxis of COVID-19 in healthy volunteers (Phase 1) and immunocompromised individuals (Phase 2a).
Protocol code: EVEREST-2
Sponsor: Spikimm (Pharmaceutical company). Phase: Phase I and Phase II (Integrated)- First administration to humans. Countries: France (ended).
Therapeutic area(s): Diseases [C] - Virus Diseases [C02]
Gender: Female, Male. Age: 18-64 years. Enrolment: 78.
Start date (EU): 2023-07-10. Decision date: 2023-07-03. Results received: No. Last updated: 2023-07-03.

Condition(s): Immunocompromised individuals (phase 2a), Healthy volunteers (Phase 1)

Source: https://euclinicaltrials.eu/ctis-public/view/2023-505279-62-00